EU clinical trial 2023-505835-11-00: I5Q-MC-CGAT:A Randomized, Double-Blind, Placebo-Controlled Study of Galcanezumab in Adolescent Patients 12 to 17 Years of Age with Chronic Migraine – the REBUILD-2 Study
Protocol code: I5Q-MC-CGAT
Sponsor: Eli Lilly & Co. (Pharmaceutical company). Phase: Therapeutic confirmatory (Phase III). Countries: Denmark (ongoing, recruitment ended), Spain (ongoing, recruitment ended), France (ongoing, recruitment ended), Netherlands (ongoing, recruitment ended), Italy (ongoing, recruitment ended).
Therapeutic area(s): Diseases [C] - Nervous System Diseases [C10]
Gender: Female, Male. Age: 0-17 years. Enrolment: 93.
Status: Ongoing, recruitment ended. Start date (EU): 2021-03-12. Decision date: 2023-11-20. Results received: No. Last updated: 2026-07-06.
Decision dates by country: IT: 2023-12-11, FR: 2023-12-05, DK: 2023-11-20, ES: 2023-11-20, NL: 2023-11-24

Condition(s): Chronic Migraine
Product: Galcanezumab, Placebo to match LY2951742

Primary endpoint: Change from Baseline in the Number of Monthly Migraine Headache Days [Time Frame: Baseline, 3 Months]

Source: https://euclinicaltrials.eu/ctis-public/view/2023-505835-11-00